EU clinical trial 2024-514495-41-00: A Phase 3, randomized, double-blind, efficacy and safety study comparing SAR442168 to placebo in participants with primary progressive multiple sclerosis (PERSEUS)
Protocol code: EFC16035
Sponsor: Genzyme Corp. (Pharmaceutical company). Phase: Therapeutic confirmatory (Phase III). Countries: Belgium (ended), France (ended), Austria (ended), Croatia (ended), Portugal (ended), Hungary (ended), Poland (ended), Netherlands (ended), Italy (ended), Bulgaria (ended), Denmark (ended), Estonia (ended), Spain (ended), Germany (ended), Czechia (ended), Greece (ended), Sweden (ended), Norway (ended), Romania (ended).
Therapeutic area(s): Diseases [C] - Nervous System Diseases [C10]
Gender: Female, Male. Age: 18-64 years. Enrolment: 487.
Status: Ended. Start date (EU): 2020-11-04. End date (EU): 2025-11-14. End date: 2025-11-15. Decision date: 2024-07-17. Results received: No. Last updated: 2025-12-17.
Decision dates by country: PL: 2024-08-04, ES: 2024-07-23, CZ: 2024-07-17, DE: 2024-08-01, RO: 2024-07-31, SE: 2024-07-22, FR: 2024-07-22, GR: 2024-10-01, HU: 2024-07-18, HR: 2024-07-19, NO: 2024-07-18, BG: 2024-08-06, DK: 2024-07-22, NL: 2024-07-18, PT: 2024-07-17, BE: 2024-07-18, AT: 2024-07-22, EE: 2024-07-19, IT: 2024-07-24

Condition(s): Primary Progressive Multiple Sclerosis
Product: mannitol and microcrystalline cellulose, Tolebrutinib

Primary endpoint: 6-month composite Confirmed Disability Progression (cCDP)
Endpoint(s): 6-month Confirmed Disability Progression (CDP), 3-month composite Confirmed Disability Progression (cCDP), Change in T2 hyperintense lesions by MRI, Time to onset of confirmed disability improvement (CDI), Percent change in Brain volume (BV), Change in cognitive function as assessed by SDMT, Change in cognitive function as assessed by CVLT-II, Change in Multiple Sclerosis Quality of Life, Safety and Tolerability, Population pharmacokinetics, Change in plasma neurofilament light chain (NfL), Change in lymphocyte phenotype subsets, Changes in serum Immunoglobulin level, Change in serum chitinase-3 like protein 1 (Chi3L1)

Source: https://euclinicaltrials.eu/ctis-public/view/2024-514495-41-00